EU clinical trial 2022-502437-25-00: A randomized, phase II, open-label, multicenter study investigating efficacy and safety of anti-PD-1/PD-L1 treatment +/- UV1 vaccination as first line treatment in patients with inoperable advanced or metastatic non-small cell lung cancer
Sponsor: Vestre Viken HF (Hospital/Clinic/Other health care facility). Phase: Therapeutic exploratory (Phase II). Countries: Norway (ended).
Therapeutic area(s): Diseases [C] - Neoplasms [C04]
Gender: Female, Male. Age: 18-64 years, 65+ years. Enrolment: 141.
Status: Ended. Start date (EU): 2022-08-15. End date (EU): 2024-09-12. Decision date: 2023-08-03. Results received: No. Last updated: 2024-12-04.

Condition(s): advanced or metastatic non-small cell lung cancer
Product: Leukine, UV1

Primary endpoint: Progression-free survival (PFS) per Response Evaluation Criteria in Solid Tumours (RECIST v1.1) as determined by Blinded Independant Central Review (BICR)
Endpoint(s): Overall Survival (OS), Objective Response Rate (ORR), Disease Control Rate (DCR), Time To Recurrence (TtR), Duration of Response (DoR)

Source: https://euclinicaltrials.eu/ctis-public/view/2022-502437-25-00